EU clinical trial 2024-510590-14-00: Allogeneic stem cell transplantation vs. conventional therapy as salvage therapy for relapsed / progressive patients with multiple myeloma after a first-line therapy
Protocol code: AlloRelapseMMStudy
Sponsor: University Medical Center Hamburg-Eppendorf (Hospital/Clinic/Other health care facility). Phase: Therapeutic confirmatory (Phase III). Countries: Germany (ended).
Therapeutic area(s): Diseases [C] - Neoplasms [C04]
Gender: Female, Male. Age: 18-64 years, 65+ years. Enrolment: 400.
Status: Ended. Start date (EU): 2023-03-03. End date (EU): 2025-01-30. Decision date: 2024-09-02. Results received: Yes. Last updated: 2025-02-05.

Condition(s): multiple myeloma
Product: Imnovid 3 mg hard capsules, Imnovid 2 mg hard capsules, SARCLISA 20mg/mL concentrate for solution for infusion., Empliciti 400 mg powder for concentrate for solution for infusion., Revlimid 5 mg hard capsules, Fortecortin® Inject 8 mg Injektionslösung in einer Ampulle, Fortecortin® Inject 40 mg Injektionslösung in einer Ampulle, Imnovid 3 mg hard capsules, Fortecortin® Inject 4 mg Injektionslösung in einer Ampulle, Fortecortin® 8 mg Tabletten, DARZALEX 20 mg/mL concentrate for solution for infusion, NEXPOVIO 20 mg film-coated tablets, NINLARO 4 mg hard capsules, Fortecortin® 4 mg Tabletten, Fortecortin® 2 mg Tabletten, Fortecortin® Inject 100 mg Injektionslösung in einer Ampulle, Revlimid 10 mg hard capsules, Fortecortin® 0,5 mg Tabletten, SARCLISA 20mg/mL concentrate for solution for infusion., Imnovid 1 mg hard capsules, NEXPOVIO 20 mg film-coated tablets, Kyprolis 10 mg powder for solution for infusion, Revlimid 10 mg hard capsules, VELCADE 3.5 mg powder for solution for injection, Revlimid 5 mg hard capsules, DARZALEX 1800 mg solution for injection, Empliciti 300 mg powder for concentrate for solution for infusion., Imnovid 1 mg hard capsules, NEXPOVIO 20 mg film-coated tablets, Imnovid 2 mg hard capsules, DARZALEX 20 mg/mL concentrate for solution for infusion, NEXPOVIO 20 mg film-coated tablets, SARCLISA 20mg/mL concentrate for solution for infusion., Kyprolis 60 mg powder for solution for infusion, NINLARO 3 mg hard capsules, DARZALEX 20 mg/mL concentrate for solution for infusion, Bortezomib medac 3,5 mg Pulver zur Herstellung einer Injektionslösung, NEXPOVIO 20 mg film-coated tablets, Kyprolis 30 mg powder for solution for infusion, NINLARO 2.3 mg hard capsules

Primary endpoint: Overall survival (OS) at five years after randomization (Patient observed from randomization until database lock for final analysis and overall survival rate calculated at 5 years after randomization)
Endpoint(s): Event-free survival (EFS) at 1 year after randomization (Patient observed from randomization until database lock for final analysis and EFS rate calculated at 1 year after randomization). Event defined as: • Progression (according to IMWG criteria) or • Relapse (according to IMWG criteria) or • Engraftment Failure (defined as no stable neutrophil count > 0.5 x 109/l on day 28 after SCT, see 11.2.12) or • Death of any cause, Event-free survival at 3 years after randomization (Patient observed from randomization until database lock for final analysis and EFS rate calculated at 3 years after randomization) Event defined as: • Progression (according to IMWG criteria) or • Relapse (according to IMWG criteria) or • Engraftment Failure (defined as no stable neutrophil count > 0.5 x 109/l on day 28 after SCT, see 11.2.12) or • Death of any cause, Event-free survival at 5 years after randomization (Patient observed from randomization until database lock for final analysis and EFS rate calculated at 5 years after randomization) Event defined as: • Progression (according to IMWG criteria) or • Relapse (according to IMWG criteria) or • Engraftment Failure (defined as no stable neutrophil count > 0.5 x 109/l on day 28 after SCT, see 11.2.12) or • Death of any cause, Change from baseline in total EORTC score at 1 year after randomization (Patient observed from baseline until database lock for final analysis and adjusted mean calculated at 1 year after randomization), Change from baseline in total EORTC score at 3 years after randomization (Patient observed from baseline until database lock for final analysis and adjusted mean calculated at 3 years after randomization), Change from baseline in total EORTC score at 5 years after randomization (Patient observed from baseline until database lock for final analysis and adjusted mean calculated at 5 years after randomization), Time to first occurrence of remission (partial or complete) after randomization (Patient is followed from randomization until database lock for final analysis and cumulative incidence of first remission, at 2 years after randomization, is reported), Non-relapse mortality (NRM) at 1 year after randomization (Patient observed from randomization until database lock for final analysis and cumulative incidence of death before any relapse at 1 year after randomization reported), Non-relapse mortality (NRM) at 3 years after randomization (Patient observed from randomization until database lock for final analysis and cumulative incidence of death before any relapse at 3 years after randomization reported), Non-relapse mortality (NRM) at 5 years after randomization (Patient observed from randomization until database lock for final analysis and cumulative incidence of death before any relapse at 5 years after randomization reported), Cumulative incidence of acute graft-versus-host disease (GvHD) after allogeneic stem cell transplantation (according to Przepiorka et al.[1]) at 1 year after randomization (Patient observed from randomization until database lock for final analysis and cumulative incidence of any acute GvHD at 1year after randomization reported), Cumulative incidence of acute GvHD after allogeneic stem cell transplantation (according to Przepiorka et al.[1]) at 3 years after randomization (Patient observed from randomization until database lock for final analysis and cumulative incidence of any acute GvHD at 3 years after randomization reported, Cumulative incidence of acute GvHD after allogeneic stem cell transplantation (according to Przepiorka et al. [1]) at 5 years after randomization (Patient observed from randomization until database lock for final analysis and cumulative incidence of any acute GvHD at 5 years after randomization reported), Cumulative incidence of chronic GvHD after allogeneic stem cell transplantation (according to Jagasia et al.[2]) at 1 year after randomization (Patient observed from randomization until database lock for final analysis and cumulative incidence of any chronic GvHD at 1 year after randomization reported), Cumulative incidence of chronic GvHD after allogeneic stem cell transplantation (according to Jagasia et al. [2]) at 3 years after randomization (Patient observed from randomization until database lock for final analysis and cumulative incidence of any chronic GvHD at 3 years after randomization reported), Cumulative incidence of chronic GvHD after allogeneic stem cell transplantation (according to Jagasia et al. [2]) at 5 years after randomization (Patient observed from randomization until database lock for final analysis and cumulative incidence of any chronic GvHD at 5 years after randomization reported), Time to first occurrence of infection reported as cumulative incidence of infection with CTCAE grade 3 - 5 at 1 year after randomization (patient observed from randomization until database lock for final analysis and cumulative incidence of any infectious complication with CTCAE grade 3 - 5 at 1 year after randomization reported)., Time to first occurrence of infection reported as cumulative incidence of infection with CTCAE grade 3 - 5 at 3 years after randomization (patient observed from randomization until database lock for final analysis and cumulative incidence of any infectious complication with CTCAE grade 3 - 5 at 3 years after randomization reported)., Time to first occurrence of infection reported as cumulative incidence of infection with CTCAE grade 3 - 5 at 5 years after randomization (patient observed from randomization until database lock for final analysis and cumulative incidence of any infectious complication with CTCAE grade 3 - 5 at 5 years after randomization reported).

Source: https://euclinicaltrials.eu/ctis-public/view/2024-510590-14-00